EU clinical trial 2023-508723-12-00: A randomized, multi-center, open-label, active-controlled Phase 3 trial to assess the efficacy and safety of octreotide subcutaneous depot (CAM2029) versus octreotide LAR or lanreotide ATG in patients with gastroenteropancreatic neuroendocrine tumors
Protocol code: HS-19-657
Sponsor: Camurus AB (Pharmaceutical company). Phase: Therapeutic confirmatory (Phase III). Countries: Romania (ongoing, recruitment ended), Spain (ongoing, recruitment ended), Hungary (ongoing, recruitment ended), Belgium (ongoing, recruitment ended), Netherlands (ongoing, recruitment ended), France (ongoing, recruitment ended), Germany (ongoing, recruitment ended), Italy (ongoing, recruitment ended).
Therapeutic area(s): Diseases [C] - Neoplasms [C04]
Gender: Female, Male. Age: 18-64 years, 65+ years. Enrolment: 234.
Status: Ongoing, recruitment ended. Start date (EU): 2021-09-27. Decision date: 2023-12-19. Results received: No. Last updated: 2026-07-20.
Decision dates by country: NL: 2023-12-20, FR: 2024-01-09, RO: 2023-12-19, BE: 2023-12-20, IT: 2023-12-22, HU: 2023-12-20, DE: 2024-01-03, ES: 2023-12-19

Condition(s): gastroenteropancreatic neuroendocrine tumors
Product: Oczyesa 20 mg prolonged-release solution for injection in pre-filled pen, Somatuline Autogel 120 mg, solution for injection in a pre-filled syringe, SANDOSTATIN LAR 30 mg powder and solvent for suspension for injection

Primary endpoint: PFS, defined as the time from the date of randomization to the date of the first documented disease progression as per Response Evaluation Criteria in Solid Tumors version 1.1 (RECIST 1.1) or death due to any cause, whichever occurs first, as assessed by a Blinded Independent Review Committee (BIRC)
Endpoint(s): PFS using RECIST 1.1 as assessed by local Investigators, Overall survival, ORR, defined as the proportion of patients with best overall response of complete response (CR) or partial response (PR) as per RECIST 1.1, DCR, defined as the proportion of patients with best overall response of CR, PR or stable disease (SD) as per RECIST 1.1, Time to response and duration of response as per RECIST 1.1, Average number of injections of octreotide rescue medication per month for each patient during the trial, Total dosage and dose intensity of rescue medication, Octreotide plasma concentrations over time, Correlation between octreotide concentration and other endpoints or measures as appropriate, Proportion of patients/partners declared competent by trial personnel to administer CAM2029 out of those trying, Change from baseline in Quality of Life Questionnaire – Neuroendocrine Carcinoid Module (QLQ-GINET21), Short Form-36 (SF-36), and the global health status/quality of life scale score of the European Organization for Research and Treatment of Cancer's Core Quality of Life Questionnaire (EORTC QLQ-C30, Treatment Satisfaction Questionnaire for Medication (TSQM) scores over time using all 4 domains of TSQM (effectiveness, side effects, convenience, and global satisfaction), Adverse events (AEs) (including local tolerability), Changes in laboratory values, vital signs, electrocardiogram readings

Source: https://euclinicaltrials.eu/ctis-public/view/2023-508723-12-00